EU clinical trial 2024-519655-28-00: OPTIMA YOUNG : Optimal Personalized Treatment of early breast cancer using Multi-parameter Analysis : focus on YOUNGer women
Protocol code: UC-BCG-2409/BIG 2402
Sponsor: Unicancer (Hospital/Clinic/Other health care facility). Phase: Therapeutic confirmatory (Phase III). Countries: Poland (authorised, recruitment pending), France (ongoing, recruiting), Italy (authorised, recruitment pending), Greece (authorised, recruitment pending), Spain (authorised, recruitment pending), Ireland (authorised, recruitment pending), Belgium (authorised, recruitment pending).
Therapeutic area(s): Diseases [C] - Neoplasms [C04]
Gender: Female. Age: 18-64 years. Enrolment: 2270.
Start date (EU): 2026-04-23. Decision date: 2025-09-23. Results received: No. Last updated: 2026-07-01.
Decision dates by country: GR: 2025-09-23, IT: 2025-09-23, PL: 2025-09-27, BE: 2026-01-29, IE: 2025-09-26, FR: 2025-09-29, ES: 2025-09-24

Condition(s): Premenopausal patients with high-risk HR-positive/HER2-negative breast cancer (BC) defined by tumour size and axillary lymph node status. One of the following must apply: a. 1-3 lymph nodes involved AND any invasive tumour size. b. node negative (including micrometastases in at least 1 node [i.e. deposit >0.2-2mm diameter]) AND invasive tumour size ≥ 50mm.
Product: TRIPTORELIN, EPIRUBICIN, DOXORUBICIN, TRIPTORELIN, GOSERELIN, ANASTROZOLE, LEUPRORELIN ACETATE, EXEMESTANE, LETROZOLE, TAMOXIFEN, DOCETAXEL, CYCLOPHOSPHAMIDE, PACLITAXEL, GOSERELIN, LEUPRORELIN ACETATE

Primary endpoint: Invasive Breast Cancer Free Survival (IBCFS) in the global population, defined according to the STEEP version 2.0 system (Tolaney et al., JCO 2021) as the time from the date of randomization to the date of the first event of ipsilateral loco-regional invasive breast cancer recurrence, distant breast cancer recurrence, contralateral new invasive primary breast cancer or death from any cause.
Endpoint(s): Same as primary enpoint but restricted to with tumours for which the Prosigna® score is below the cut-off (≤60) for chemotherapy use (approximately 70% of the total)., According to the STEEP version 2.0 system definition, in the global population : Distant recurrence free interval (DRFI), Distant recurrence free survival (DRFS), Breast cancer specific survival (BCSS), According to the STEEP version 2.0 system definition, in the global population with tumours for which the Prosigna® score is ≤60 : Distant recurrence free interval (DRFI), Distant recurrence free survival (DRFS), Breast cancer specific survival (BCSS), Overall survival (OS), QoL, physical and psychosocial symptoms and breast cancer frequent symptoms/side effects will be assessed in OPTIMA-YOUNG population* and in OPTIMA-YOUNG population with tumours for which the Prosigna® score is ≤60 using the following questionnaires: Quality of life (EORTC QLQ-C30 and BR42), Anxiety and Depression (GAD-7 and PHQ8), Cognition (FACT Cog), NCCN Distress thermometer, Return to work, Health and safety outcomes: osteoporosis (Number non-traumatic fractures), cardiovascular disease (Number of major cardiovascular events, including stroke, MI, heart failure, cardiovascular deaths), fertility (Number of pregnancies) and health behaviour : physical Activity Levels (IPAQ), BMI, tobacco and alcohol consumption Self-reported adherence to ET (VOILS) in OPTIMA-YOUNG population* and in OPTIMA-YOUNG population with tumours for which the Prosigna® score is ≤60, Communication aspects, uncertainties and fears related to participating in a de-escalation trial will be assessed using the following questionnaires : Fear of Cancer Recurrence (FCRI-SF), Motivation to enter the trial (SPECIFIC), Recall and expectation on potential treatment related toxicities (ad hoc questionnaire), Decision Conflict (SURE), Decision Regret Scale (DRS) in the OPTIMA-YOUNG population*., Cost-effectiveness analysis of Prosigna®-driven treatment compared to standard clinical practice, summarised as the incremental cost-effectiveness ratio in the patients recruited in France, Italy, Spain for the OPTIMA-YOUNG trial and United Kingdom for OPTIMA., Score of perceived ease of use (SUS) of the digital platform (WeShare) for research on the OPTIMA-YOUNG population*.

Source: https://euclinicaltrials.eu/ctis-public/view/2024-519655-28-00